EU clinical trial 2023-506305-18-01: An open-label, fixed sequence drug interaction study in healthy subjects to investigate the effect of multiple doses of the gastric acid-reducing agent rabeprazole on the single dose pharmacokinetics of a 40 mg deucrictiban extended-release (XR) tablet.
Protocol code: PHA022121-C014
Sponsor: Pharvaris Netherlands B.V. (Pharmaceutical company). Phase: Human Pharmacology (Phase I)- Other. Countries: Germany (ended).
Therapeutic area(s): Diseases [C] - Congenital, Hereditary, and Neonatal Diseases and Abnormalities [C16]
Gender: Female, Male. Age: 18-64 years. Enrolment: 14.
Status: Ended. Start date (EU): 2024-09-19. End date (EU): 2024-12-12. Decision date: 2024-09-09. Results received: No. Last updated: 2024-09-09.

Condition(s): Hereditary angioedema

Source: https://euclinicaltrials.eu/ctis-public/view/2023-506305-18-01